EU clinical trial 2024-511791-32-00: A Clinical Phase II, multicenter, Open-label study evaluating iNduction, consolidation and maintenance treatment with Isatuximab (SAR650984), Carfilzomib, LEnalidomide and Dexamethasone (I-KRd) in Primary diagnosed high-risk multiple myeloma paTients _ GMMG-CONCEPT
Protocol code: GMMG-CONCEPT
Sponsor: University Medical Center Hamburg-Eppendorf (Hospital/Clinic/Other health care facility). Phase: Therapeutic exploratory (Phase II). Countries: Germany (ongoing, recruitment ended).
Therapeutic area(s): Diseases [C] - Hemic and Lymphatic Diseases [C15]
Gender: Female, Male. Age: 18-64 years, 65+ years. Enrolment: 246.
Status: Ongoing, recruitment ended. Start date (EU): 2017-08-15. Decision date: 2024-09-16. Results received: No. Last updated: 2025-10-06.

Condition(s): Multiple Myeloma
Product: Revlimid 10 mg hard capsules, Revlimid 25 mg hard capsules, Kyprolis 60 mg powder for solution for infusion, Revlimid 15 mg hard capsules, SARCLISA 20mg/mL concentrate for solution for infusion., Revlimid 5 mg hard capsules

Primary endpoint: MRD negativity (sensitivity 10^-5, NGF) after consolidaton
Endpoint(s): Progression free survival

Source: https://euclinicaltrials.eu/ctis-public/view/2024-511791-32-00